EU clinical trial 2023-507426-17-00: A Phase 3b/4, Interventional, Multicenter, Open-Label, Single-Arm Study to Assess Behavioral and Other Co-occurring Outcomes Following Treatment With EPID(I/Y)OLEX as Add-on Therapy in Participants (Aged 1 to 65 Years Old) With Seizures Associated With Tuberous Sclerosis Complex (EpiCom)
Protocol code: JZP926-402
Sponsor: Jazz Pharmaceuticals Research UK Limited (Pharmaceutical company). Phase: Phase III and phase IV (Integrated). Countries: Poland (ended).
Therapeutic area(s): Diseases [C] - Nervous System Diseases [C10]
Gender: Female, Male. Age: 0-17 years, 18-64 years. Enrolment: 20.
Status: Ended. Start date (EU): 2024-11-12. End date (EU): 2026-03-10. End date: 2026-04-06. Decision date: 2024-05-06. Results received: No. Last updated: 2025-08-29.

Condition(s): Tuberous Scerlosis Complex
Product: Epidyolex 100 mg/ml oral solution

Primary endpoint: Change from baseline in the most problematic behavior NRS score within the TAND-SQ at Weeks 13, 26, and 52
Endpoint(s): Change from baseline in TAND-SQ at Weeks 13, 26, and 52., Change from baseline in ABC at Weeks 13, 26, and 52, Change from baseline in CBCL/ABCL/ASR at Weeks 26, and 52, Change from baseline to Weeks 26 and 52 in PROMIS domains, Change from baseline in sleep characteristics in CSHQ/PSQI at Week 26, Change from baseline in executive function using the BRIEF at Week 26, Change from baseline in caregiver-reported assessment of QOL and family functioning using PedsQL FIM to Week 26, Change from baseline in assessment of QOL using PedsQL to Week 26, Change from baseline in caregiver/participant and clinician impression of overall severity of symptoms (behavior and seizure control) utilizing CareGI-S/PGI-S and CGI-S at Weeks 4, 13, 26, and 52, Retention at Weeks 13, 26, and 52 following initiation of treatment, Number of participants considered treatment responders from baseline to each evaluable visit, Number of participants experiencing a worsening, no change, or improvement in seizure frequency from baseline to each evaluable visit, Change in number of seizure-free days from baseline at Weeks 4, 13, 26, and 52, Change from baseline in the following measures at Weeks 4, 13, 26, and 52 (where available): most problematic behavior NRS (within TAND-SQ), TAND-SQ, ABC, CBCL/ABCL/ASR, BRIEF, PROMIS, CGI-S, and PGI-S/CareGI-S, Incidence and/or severity of TEAEs, Changes from baseline to each evaluable visit in clinical laboratory parameters and incidence of abnormal values, Change from baseline to each evaluable visit in ideation score and number of suicide attempts per the C-SSRS or Children’s C-SSRS (where applicable), Number of participant inpatient hospitalizations due to epilepsy, Number of withdrawals due to TEAEs

Source: https://euclinicaltrials.eu/ctis-public/view/2023-507426-17-00